EU clinical trial 2023-505884-35-00: Absorbed Tumor Dose in Peptide Receptor Radionuclide Therapy with long-acting Somatostatin Analogues – ATSA trial
Sponsor: Het Nederlands Kanker Instituut-Antoni van Leeuwenhoek Ziekenhuis Stichting (Hospital/Clinic/Other health care facility). Phase: Therapeutic use (Phase IV). Countries: Netherlands (ongoing, recruiting).
Therapeutic area(s): Diseases [C] - Neoplasms [C04]
Gender: Female, Male. Age: 18-64 years, 65+ years. Enrolment: 34.
Status: Ongoing, recruiting. Start date (EU): 2024-06-17. Decision date: 2024-01-15. Results received: No. Last updated: 2026-06-17.

Condition(s): The study population includes all patients aged over 18 with a neuroendocrine tumor grade I and II and a clinical indication for PRRT.
Product: LUTETIUM (177LU) OXODOTREOTIDE, OCTREOTIDE, LANREOTIDE

Primary endpoint: The absorbed dose in target lesions measured on SPECT/CT imaging
Endpoint(s): The absorbed dose in normal tissue (kidneys, liver, spleen) measured on SPECT/CT imaging, The bone marrow dose is determined using blood withdrawals and SPECT/CT imaging, The uptake on SPECT/CT between target lesions and the liver and spleen measured on the 24 hours’ time point, The effect of continued LA-SSA use on specific population pharmacokinetic parameters will be qualified using population pharmacokinetic modelling using the acquired SPECT/CT scans and blood samples for dosimetry

Source: https://euclinicaltrials.eu/ctis-public/view/2023-505884-35-00